EU clinical trial 2023-505053-40-00: Subcutaneous immunoglobulin (HyQvia) against early infections in multiple myeloma: SHIELD
Sponsor: Lillebaelt Hospital (Hospital/Clinic/Other health care facility). Phase: Therapeutic exploratory (Phase II). Countries: Denmark (ongoing, recruitment ended), Norway (ongoing, recruitment ended), Estonia (ongoing, recruitment ended).
Therapeutic area(s): Diseases [C] - Neoplasms [C04]; Diseases [C] - Hemic and Lymphatic Diseases [C15]
Gender: Female, Male. Age: 18-64 years, 65+ years. Enrolment: 100.
Status: Ongoing, recruitment ended. Start date (EU): 2023-11-30. Decision date: 2023-09-08. Results received: No. Last updated: 2026-03-10.
Decision dates by country: EE: 2023-09-13, NO: 2023-09-08, DK: 2023-09-08

Condition(s): Multiple Myeloma
Product: HyQvia 100 mg/ml solution for infusion for subcutaneous use

Primary endpoint: The primary endpoint of the study is the annualized incidence of severe infections. (Severe is defined as Common Terminology Criteria for Adverse Events version 5.0 grade 2 or higher.)
Endpoint(s): Number of days on systemic antibiotic therapy for the treatment of infections (not prophylaxis), Number of days on systemic antiviral or antifungal therapy for the treatment of infections (not prophylaxis), Number of days admitted to hospital due to infections, Number of days on intravenous antibiotic treatment, Time to first severe infection, Time to second severe infection, Number, type, and severity of microbiologically defined infections, Number of blood culture days, Overall survival 6 and 12 months after randomization, Infection-related mortality 6 and 12 months after randomization, Serum non-monoclonal IgG trough levels at 3, 6, 9 and 12 months after randomization, Susceptibility to infections depending on M-protein isotype, Susceptibility to infections based on response to anti-myeloma treatment, Patient reported outcome assessment on health-related quality of life, Susceptibility to infections depending on serum anti-pneumococcal polysaccharide IgG antibody levels, Susceptibility to infections depending on peripheral blood CD4+ lymphocyte counts, Susceptibility to infections depending on estimated serum non-monoclonal IgG levels by Hevylite assay, Susceptibility to infections depending on serum IgG subclass deficiency

Source: https://euclinicaltrials.eu/ctis-public/view/2023-505053-40-00